EU clinical trial 2022-501636-42-00: A Modular, Open-label, Phase I/II Study to Evaluate the Safety, Tolerability, Pharmacokinetics and Efficacy of EP0031 in Patients with Advanced RET-altered Malignancies
Protocol code: EP0031-101
Sponsor: Ellipses Pharma Limited (Pharmaceutical company). Phase: Phase I and Phase II (Integrated)- Other. Countries: Spain (ongoing, recruiting), France (ongoing, recruiting), Germany (ongoing, recruiting), Italy (ongoing, recruiting), Poland (ongoing, recruiting).
Therapeutic area(s): Diseases [C] - Neoplasms [C04]
Gender: Female, Male. Age: 18-64 years, 65+ years. Enrolment: 120.
Status: Ongoing, recruiting. Start date (EU): 2023-03-21. Decision date: 2023-02-10. Results received: No. Last updated: 2026-07-13.
Decision dates by country: IT: 2025-10-21, DE: 2025-10-24, ES: 2023-02-10, PL: 2025-10-26, FR: 2023-08-07

Condition(s): Advanced RET-altered malignancies
Product: PEMETREXED, CISPLATIN, CARBOPLATIN

Primary endpoint: Module A: Incidence of DLTs, AEs, SAEs, and changes in laboratory parameters, physical examination, vital signs, and ECG Modules B & C: Tumour response as per RECIST v1.1 (ORR, BOR, DOR, TTR, change in tumour size), PFS and OS. Module B: Incidence of DLTs, AEs, SAEs, and changes in laboratory parameters, physical examination, vital signs, and ECG
Endpoint(s): Module A: Plasma PK parameters (AUC0-48, AUClast, AUCinf, Cmax and/or Cmin, tmax, t½, CL/F, V/F, and/or Vz/F) after single and multiple doses. Modules B & C: Incidence of AEs, SAEs, and changes in laboratory parameters, physical examination, vital signs, and ECG Plasma PK parameters (eg, AUC0-48, AUClast, AUCinf, Cmax and/or Cmin, tmax, t½, CL/F, V/F, and/or Vz/F)., Module B: Tumour response as per RECIST v1.1 (ORR, BOR, DOR, TTR, change in tumour size), PFS and OS. Plasma PK parameters (eg, AUC0-48, AUClast, AUCinf, Cmax and/or Cmin, tmax, t½, CL/F, V/F, and/or Vz/F) after single and multiple doses

Source: https://euclinicaltrials.eu/ctis-public/view/2022-501636-42-00